EU clinical trial 2024-514156-33-00: MAINEPSAN : A Prospective Comparative Randomized Double-blind Placebo-controlled In-Parallel Groups Multicenter, Study to Evaluate the remission MAINtenance using Extended administration of Prednisone in Systemic anti-neutrophil cytoplasmic antibodies (ANCA)-associated vasculitis.
Sponsor: Hospices Civils De Lyon (Hospital/Clinic/Other health care facility). Phase: Therapeutic confirmatory (Phase III). Countries: France (ongoing, recruiting).
Therapeutic area(s): Phenomena and Processes [G] - Immune system processes [G12]
Gender: Female, Male. Age: 18-64 years, 65+ years. Enrolment: 146.
Status: Ongoing, recruiting. Start date (EU): 2019-08-20. Decision date: 2024-06-17. Results received: No. Last updated: 2026-07-01.

Condition(s): Patients in remission for granulomatosis with polyangiitis (GPA, Wegener's) or microscopic polyangiitis (MPA) achieved with rituximab or cyclophosphamide or methotrexate
Product: MabThera 500 mg concentrate for solution for infusion, MICROCRYSTALLINE CELLULOSE, CORTANCYL 1 mg, comprimé

Primary endpoint: relapse-free survival at Month 30 (18 months after last rituximab maintenance infusion), relapse being defined as BVAS >0.
Endpoint(s): Proportion of patients with at least one AE between Day 1 and Month 30,, Percentage of patients with at least one minor or major vasculitis flare (BVAS>0) or one predefined severe event corresponding to AE of grade 3 to 5 of the Common Terminology Criteria, including severe side effect related to glucocorticoids (infection requiring hospitalization or intravenous antibiotics, osteoporotic fracture, diabetes requiring medication, cardiovascular event, osteonecrosis, psychiatric or mood disorder requiring drug administration, weight gain >10 kg), between D1 and M30, Percentage of patients with at least one SAE between Day 1 and Month 30 corresponding to any AE that results in death, is life-threatening, requires inpatient hospitalisation or prolongation of existing hospitalisation, results in persistent or significant disability/incapacity or congenital anomaly/birth defect or any other AE considered "medically significant",, Percentage of patients with minor (reappearance or worsening of disease with a BVAS >0, not corresponding to a major relapse but requiring mild treatment intensification) or major vasculitis (occurrence or new onset of potentially organ- or life-threatening disease activity that cannot be treated with an increase of glucocorticoids alone and requires further escalation of treatment) between Day 1 and Month 30 (BVAS >0) and time to first vasculitis relapse,, Variation of GTI toxicity score between Day 1 and Month 30,, Prednisone area under the curve of administrated dose between Day 1 and Month 30,, Number of deaths, whatever the cause at Month 30,, Variation of the bone mineral density between Day 1 and Month 30,

Source: https://euclinicaltrials.eu/ctis-public/view/2024-514156-33-00